EU clinical trial 2023-508291-11-00: Impact of dextroamphetamine substitution on the use of illicit amphetamines in adults with comorbid dependencies to amphetamines and opioids undergoing opioid agonist treatment: A multi-center double blind randomized controlled study (ATLAS4Dependence)
Sponsor: Helse Bergen HF (Hospital/Clinic/Other health care facility). Phase: Therapeutic exploratory (Phase II). Countries: Norway (ongoing, recruiting).
Therapeutic area(s): Psychiatry and Psychology [F] - Mental Disorders [F03]
Gender: Female, Male. Age: 18-64 years. Enrolment: 226.
Status: Ongoing, recruiting. Start date (EU): 2024-09-18. Decision date: 2024-03-22. Results received: No. Last updated: 2026-05-28.

Condition(s): Comorbid dependencies to amphetamines and opioids
Product: Dexamfetamine, Placebo matching active treatment

Primary endpoint: a) The differences in the proportion positive urinary tests on illicit amphetamines and b) mean total self-reported quantity* (mg/day) of amphetamines use between the intervention and control arm during 12-week trial (cumulative data). * Dosage of illicit amphetamines will be converted to prescribed dexamphetamine dosage and added to the prescribed dosage
Endpoint(s): Psychological distress (SCL-10), Psychosis (PANSS: P1, P3, A9)/ LSHS-E, ADHD (ASRS), Quality of life (EQ-5D-5L), Executive cognitive performance (TMT B), Fatigue (FSS-3), Treatment satisfaction (VAS), Adherence to OAT (days of drop-out), Days of use of illicit amphetamines (at the end of the 12 weeks), Days of use and porpotion of other illicit substances and alcohol (self-reports and urinary tests), Injection-related infections (medical records) and HCV RNA incidence, Violence risk (BVC)/(PANSS: P4 and P7), Criminality (criminal actions), Sleep (ISI), Private economy (total and health-related), Craving and withdrawals to amphetamines, Sucidality risk at the end of 12-week trial.

Source: https://euclinicaltrials.eu/ctis-public/view/2023-508291-11-00